EU clinical trial 2024-512629-97-00: BFR ESS - A randomized comparative, prospective, multicentre phase II study evaluating the clinical impact of interruption versus maintenance of aromatase inhibitors in patients with locally advanced or metastatic low grade endometrial stromal sarcoma
Protocol code: ET17-200
Sponsor: Centre Leon Berard (Hospital/Clinic/Other health care facility). Phase: Therapeutic exploratory (Phase II). Countries: France (ongoing, recruiting).
Therapeutic area(s): Diseases [C] - Neoplasms [C04]
Gender: Female. Age: 18-64 years. Enrolment: 40.
Status: Ongoing, recruiting. Start date (EU): 2019-01-23. Decision date: 2024-09-19. Results received: No. Last updated: 2026-05-13.

Condition(s): Patients with locally advanced or metastatic low grade endometrial stroma sarcoma
Product: ARIMIDEX 1 mg, comprimé pelliculé, AROMASINE 25 mg, comprimé enrobé, LETROZOLE

Primary endpoint: Progression-Free Survival (PFS), defined as the time from date of randomization to date of the first documented radiological progression (RECIST 1.1) or death due to any cause.
Endpoint(s): Between arms: ✓ the overall survival (OS)✓ the safety, ✓ the Quality of Life (QoL), ✓ the time to first subsequent chemotherapy;, The progression-free survival (PFS) after AI reintroduction in the experimental arm, The objective response rate (ORR) after reintroduction of AI in the experimental arm, The duration of response to AI after reintroduction in the experimental arm.

Source: https://euclinicaltrials.eu/ctis-public/view/2024-512629-97-00